EU clinical trial 2024-515273-10-00: A Phase 1/2a, First-in-human Study to Evaluate the Safety, Tolerability, Pharmacokinetics, and Efficacy of HDP 101 in Patients with Plasma Cell Disorders Including Multiple Myeloma
Protocol code: HDP-101-01
Sponsor: Heidelberg Pharma AG (Pharmaceutical company). Phase: Phase I and Phase II (Integrated)- First administration to humans. Countries: Hungary (ongoing, recruiting), Poland (ongoing, recruiting), Germany (ongoing, recruiting), Romania (ongoing, recruiting), Spain (authorised, recruitment pending).
Therapeutic area(s): Diseases [C] - Neoplasms [C04]
Gender: Female, Male. Age: 18-64 years, 65+ years. Enrolment: 111.
Start date (EU): 2021-10-19. Decision date: 2024-08-23. Results received: No. Last updated: 2026-06-29.
Decision dates by country: PL: 2024-09-02, RO: 2026-05-18, ES: 2026-05-14, HU: 2024-08-27, DE: 2024-08-23

Condition(s): Relapsed or refractory Multiple Myeloma (r/r MM)
Product: HDP-101

Primary endpoint: Phase 1: Number of patients who experience a dose-limiting toxicity (DLT) during the first cycle of treatment. Phase 2a: Objective response rate (ORR).

Source: https://euclinicaltrials.eu/ctis-public/view/2024-515273-10-00